EU clinical trial 2024-513037-20-00: A Multicenter, Randomized, Double-blind, Placebo-controlled Study to Assess the Efficacy and Safety of Lumateperone in the Acute Treatment of Patients with Manic Episodes or Manic Episodes with Mixed Features Associated with Bipolar I Disorder (Bipolar Mania)
Protocol code: ITI-007-452
Sponsor: Intra-Cellular Therapies Inc. (Pharmaceutical company). Phase: Therapeutic confirmatory (Phase III). Countries: Bulgaria (ended), Romania (ended).
Therapeutic area(s): Psychiatry and Psychology [F] - Mental Disorders [F03]
Gender: Female, Male. Age: 18-64 years, 65+ years. Enrolment: 60.
Status: Ended. Start date (EU): 2024-12-19. End date (EU): 2026-04-17. End date: 2026-05-20. Decision date: 2024-11-15. Results received: No. Last updated: 2026-05-19.
Decision dates by country: BG: 2024-11-18, RO: 2025-04-04

Condition(s): Bipolar I Disorder (Bipolar Mania)
Product: The placebo capsules are identical in appearance to the lumateperone capsules and have the same excipient ingredients as lumateperone but do not have the active compound.

Primary endpoint: Change from baseline to end of Week 3 in YMRS total score
Endpoint(s): Change from baseline to end of Week 3 in CGI-S score

Source: https://euclinicaltrials.eu/ctis-public/view/2024-513037-20-00